EU clinical trial 2023-510492-57-00: A prospective randomized single blind multicenter phase II study of organ perfusion with Custodiol-N compared with Custodiol in heart transplantation in children (CL-N-HTX-Paed-II/10/20)
Protocol code: CL-N-HTX-Paed
Sponsor: Dr. Franz Koehler Chemie GmbH (Pharmaceutical company). Phase: Therapeutic exploratory (Phase II). Countries: Germany (ongoing, recruiting).
Therapeutic area(s): Diseases [C] - Cardiovascular Diseases [C14]
Gender: Female, Male. Age: 0-17 years. Enrolment: 15.
Status: Ongoing, recruiting. Start date (EU): 2025-03-05. Decision date: 2024-05-24. Results received: No. Last updated: 2026-07-01.

Condition(s): heart transplantation in children
Product: CUSTODIOL® - Perfusionslösung, Custodiol-N

Primary endpoint: Safety assessment, i.e. continuous adverse event reporting up to 3 months
Endpoint(s): Vital parameters (heart rate, blood pressure, body temperature) up to day 7, Laboratory tests including cardiac troponin and creatinine kinase (CK-MB) up to day 7o CK-MB peak value from 4 to 168 hours after release of the aortic cross clamp (measurements 4,8,12,16,20,24± 30min; 32h,40h,48h,56h,64h,72h ± 2 hours; visit 4-7 one time/interval) o CK-MB AUC value visit 1-7 o Troponin T up to 168 hours after release of the aortic cross clamp (measurements 4,8,12,16,20,24hours ± 30 min;32h,40h,48h,56h,64h,72h ± 2hours; visit 4-7 one time/interval) o Troponin AUC value visit 1-7, Hematology and clinical chemistry pre-operative and on visit 1,3,7 post-transplantation., Haemodynamics at termination of cardiopulmonary bypass, and after 4h, 8h and 12h after aortic cross clamp release but only until transfer to intensive care unit (SBP, DBP), HR, PAP (if available), CVR (if available), Death up to 3 months, Graft survival up to 12 months, Readmission to ICU up to 12 months, Length of ICU stays up to 12 months, Catecholamine requirement (yes/no) up to day 7, Antihypertensiva intake (yes/no) up to 3 months, Milrinone support (yes/no) up to day 7, Need for pacemaker therapy (yes/no) up to day 7 and up to 12 months, Device therapy (each yes/no) up to 12 months (including LVAD, RVAD,ECMO, BIVAD or percutaneuos LVAD), Echocardiographic markers of function and rejection up to day 7 (Ejection fraction, enddiastolic and endsystolic ventricle volume), Cardiac arrhythmias up to day 7 (occurrence, severity, type)

Source: https://euclinicaltrials.eu/ctis-public/view/2023-510492-57-00